EU clinical trial 2024-512370-94-00: Multicentric phase II trial to evaluate the efficacy and safety of Ibrutinib in combination with rituximab in patients with indolent clinical forms of Mantle Cell Lymphoma.
Protocol code: GELTAMO-IMCL-2015
Sponsor: Fundacion Geltamo (Patient organisation/association). Phase: Therapeutic exploratory (Phase II). Countries: Spain (ongoing, recruitment ended).
Therapeutic area(s): Diseases [C] - Neoplasms [C04]
Gender: Female, Male. Age: 18-64 years, 65+ years. Enrolment: 50.
Status: Ongoing, recruitment ended. Start date (EU): 2024-06-13. Decision date: 2024-06-13. Results received: No. Last updated: 2025-12-12.

Condition(s): Mantle Cell Lymphoma
Product: MabThera 100 mg concentrate for solution for infusion, IMBRUVICA 140 mg hard capsules

Primary endpoint: Rate of complete remission (CR) achieved at 12 months of I+R combination.
Endpoint(s): To determine the overall response rate (ORR) at 12 months, Progression free survival (PFS), duration of response (DOR) and overall survival (OS)., To determine the rate of negative minimal residual disease (MRD), the time to obtain a molecular response and the median duration of the molecular response in I+R responding patients., Rates of AEs, SAEs, and SUSARs by CTC grade (Version 4.03) during I+R treatment, To assess the health-related quality of life (QOL) during treatment., Genomic studies in indolent clinical forms of MCL (IGHV mutational status, DNA copy-number and whole exome sequencing)

Source: https://euclinicaltrials.eu/ctis-public/view/2024-512370-94-00